EU clinical trial 2026-525309-11-00: Exploratory, non-randomized, 3-group, microdosing clinical trial to investigate Gallium-68 (68Ga) labeled Platelet-Derived Growth Factor Beta (PDGFRß) targeting Positron Emission Tomography (PET) tracer (68Ga-ATH001) binding in the lungs in healthy participants versus participants with Systemic Sclerosis-associated Interstitial Lung Disease (SSc-ILD)
Protocol code: INT010
Sponsor: Antaros Medical AB (Pharmaceutical company). Phase: Human Pharmacology (Phase I)- Other. Countries: Sweden (authorised, recruitment pending).
Therapeutic area(s): Analytical, Diagnostic and Therapeutic Techniques and Equipment [E] - Diagnosis [E01]
Gender: Female, Male. Age: 18-64 years, 65+ years. Enrolment: 15.
Status: Authorised, recruitment pending. Decision date: 2026-03-11. Results received: No. Last updated: 2026-03-11.

Condition(s): Systemic Sclerosis-associated Interstitial Lung Disease (SSc-ILD)

Source: https://euclinicaltrials.eu/ctis-public/view/2026-525309-11-00